EU clinical trial 2023-504534-21-00: Open-label extension study with Tadekinig alfa (r-hIL-18BP) to monitor safety and tolerability in patients with IL-18 driven monogenic autoinflammatory conditions: NLRC4 mutation and XIAP deficiency
Protocol code: OLE-NLRC4/XIAP
Sponsor: AB2 Bio S.A. (Pharmaceutical company). Phase: Therapeutic confirmatory (Phase III). Countries: Germany (ended).
Therapeutic area(s): Diseases [C] - Immune System Diseases [C20]
Gender: Female, Male. Age: 0-17 years. Enrolment: 1.
Status: Ended. Start date (EU): 2023-10-09. End date (EU): 2024-05-08. End date: 2024-05-09. Decision date: 2023-07-04. Results received: Yes. Last updated: 2023-11-14.

Condition(s): 18 driven monogenic autoinflammatory conditions: NLRC4 mutation and XIAP deficiency
Product: Tadekinig alfa

Primary endpoint: Safety and tolerability of Tadekinig alfa treatment evaluated by reports of adverse events, abnormal laboratory results, Local tolerability, Immunogenicity evaluation and PK/PD determination

Source: https://euclinicaltrials.eu/ctis-public/view/2023-504534-21-00